EU clinical trial 2024-514360-70-00: A Phase 1/2, Single-arm, Open-Label Trial to Evaluate the Safety and Efficacy of Nadofaragene Firadenovec Instilled to the Renal Pelvis in Adult Subjects with Low-Grade Upper Tract Urothelial Carcinoma (LG-UTUC)
Protocol code: 000425
Sponsor: Ferring Pharmaceuticals A/S (Pharmaceutical company). Phase: Phase I and Phase II (Integrated)- Other. Countries: Spain (authorised, recruitment pending), France (authorised, recruitment pending), Netherlands (authorised, recruitment pending).
Therapeutic area(s): Diseases [C] - Female Urogenital Diseases and Pregnancy Complications [C13]; Diseases [C] - Male Urogenital Diseases [C12]
Gender: Female, Male. Age: 18-64 years, 65+ years. Enrolment: 5.
Status: Authorised, recruitment pending. Decision date: 2025-09-16. Results received: No. Last updated: 2026-05-18.
Decision dates by country: NL: 2025-09-16, ES: 2025-09-22, FR: 2025-09-17

Condition(s): Low-grade upper track urothelial carcinoma (LG-UTUC)
Product: ADSTILADRIN

Primary endpoint: Primary Safety Endpoint: The number of treatment-emergent adverse events reported by each subject during the trial., Primary Efficacy Endpoint: Complete response at 3 or 6 months defined as absence of any UTUC in the renal pelvis, i.e. negative urine cytology for high-grade urothelial carcinoma (centrally assessed), and either no suspicious lesions on ureteroscopy (investigator assessed) or a negative for-cause biopsy (centrally assessed)

Source: https://euclinicaltrials.eu/ctis-public/view/2024-514360-70-00